EU clinical trial 2023-509226-21-00: A Phase 1, 2-part, open-label, single-sequence study to investigate the effect of single and multiple doses of obefazimod on the pharmacokinetics of rosuvastatin in healthy male participants.
Protocol code: ABX464-906
Sponsor: Abivax (Pharmaceutical company). Phase: Human Pharmacology (Phase I)- Other. Countries: France (ended).
Therapeutic area(s): Diseases [C] - Digestive System Diseases [C06]
Gender: Male. Age: 18-64 years. Enrolment: 24.
Status: Ended. Start date (EU): 2024-06-13. End date (EU): 2025-02-20. Decision date: 2024-03-11. Results received: No. Last updated: 2024-09-04.
Decision dates by country: FR: 2024-05-13

Condition(s): Moderately to severely active ulcerative colitis

Source: https://euclinicaltrials.eu/ctis-public/view/2023-509226-21-00